EU clinical trial 2024-513361-40-00: Évaluation de la sécurité de l’embolisation par LipiodolⓇ dans l’arthrose digitale symptomatique réfractaire au traitement conventionnel : étude pilote sur 15 patients
Sponsor: Centre Hospitalier Universitaire Grenoble Alpes (Hospital/Clinic/Other health care facility). Phase: Human Pharmacology (Phase I)- Bioequivalence Study. Countries: France (ongoing, recruiting).
Therapeutic area(s): Diseases [C] - Musculoskeletal Diseases [C05]
Gender: Female, Male. Age: 18-64 years, 65+ years. Enrolment: 15.
Status: Ongoing, recruiting. Start date (EU): 2024-12-05. Decision date: 2024-07-15. Results received: No. Last updated: 2026-03-11.

Condition(s): Arthrose digitale répondant aux critères de classification de l’American College of Rheumatology (ACR), touchant au moins deux articulations interphalangiennes proximales (IPP) et/ou distales (IPD) présentant un stade radiologique de Kellgren-Lawrence (KL) ≥ 2 et symptomatique dans les 3 derniers mois.

Source: https://euclinicaltrials.eu/ctis-public/view/2024-513361-40-00